EU clinical trial 2023-505850-16-00: A Phase 3 Randomized Study Comparing Bortezomib, Lenalidomide and Dexamethasone (VRd) followed by Ciltacabtagene Autoleucel, a Chimeric Antigen Receptor T cell (CAR-T) Therapy Directed Against BCMA versus Bortezomib, Lenalidomide, and Dexamethasone (VRd) followed by Lenalidomide and Dexamethasone (Rd) Therapy in Participants with Newly Diagnosed Multiple Myeloma for Whom Hematopoietic Stem Cell Transplant is Not Planned as Initial Therapy.
Protocol code: 68284528MMY3004
Sponsor: Janssen - Cilag International (Pharmaceutical company). Phase: Therapeutic confirmatory (Phase III). Countries: Sweden (ongoing, recruitment ended), Finland (ongoing, recruitment ended), Germany (ongoing, recruitment ended), Austria (ongoing, recruitment ended), Norway (ongoing, recruitment ended), Czechia (ongoing, recruitment ended), Denmark (ongoing, recruitment ended), Spain (ongoing, recruitment ended), Poland (ongoing, recruitment ended), Belgium (ongoing, recruitment ended), Portugal (ongoing, recruitment ended), Hungary (ongoing, recruitment ended), France (ongoing, recruitment ended), Netherlands (ongoing, recruitment ended), Greece (ongoing, recruitment ended), Ireland (ongoing, recruitment ended).
Therapeutic area(s): Diseases [C] - Neoplasms [C04]
Gender: Female, Male. Age: 18-64 years, 65+ years. Enrolment: 371.
Status: Ongoing, recruitment ended. Start date (EU): 2021-08-05. Decision date: 2024-04-11. Results received: No. Last updated: 2026-01-19.
Decision dates by country: NO: 2024-04-17, ES: 2024-04-12, AT: 2024-04-16, CZ: 2024-04-12, IE: 2024-04-11, DK: 2024-04-12, GR: 2024-05-27, SE: 2024-04-12, BE: 2024-04-18, NL: 2024-04-12, DE: 2024-04-16, PL: 2024-04-12, FR: 2024-04-17, PT: 2024-04-12, FI: 2024-04-12, HU: 2024-04-12

Condition(s): Multiple Myeloma
Product: Dexamethasone Tablets BP 2.0mg, Fortecortin® 2 mg Tabletten, Lenalidomide Accord 15 mg hard capsules, CARVYKTI 3.2 × 10^6 – 1.0 × 10^8 cells dispersion for infusion, Lenalidomide Mylan 5 mg hard capsules, Lenalidomide Mylan 20 mg hard capsules, VELCADE 3.5 mg powder for solution for injection, Lenalidomide Mylan 20 mg hard capsules, Lenalidomide Accord 10 mg hard capsules, Lenalidomide Accord 2.5 mg hard capsules, FLUDARABINE, Lenalidomide Mylan 15 mg hard capsules, Lenalidomide Accord 10 mg hard capsules, CYCLOPHOSPHAMIDE, Lenalidomide Mylan 2.5 mg hard capsules, Lenalidomide Accord 25 mg hard capsules, Lenalidomide Mylan 15 mg hard capsules, Lenalidomide Accord 20 mg hard capsules, Lenalidomide Mylan 10 mg hard capsules, Lenalidomide Accord 20 mg hard capsules, Lenalidomide Accord 5 mg hard capsules, Lenalidomide Mylan 5 mg hard capsules, Lenalidomide Accord 25 mg hard capsules, Lenalidomide Mylan 25 mg hard capsules, Lenalidomide Mylan 25 mg hard capsules, Lenalidomide Accord 2.5 mg hard capsules, Dexamethason 4 mg JENAPHARM®, Lenalidomide Accord 15 mg hard capsules, Lenalidomide Accord 5 mg hard capsules, Lenalidomide Mylan 10 mg hard capsules, Lenalidomide Mylan 2.5 mg hard capsules

Primary endpoint: Progression-free survival (PFS) with progression defined by IMWG criteria, or death, whichever occurred first.

Source: https://euclinicaltrials.eu/ctis-public/view/2023-505850-16-00